EU clinical trial 2025-522580-15-00: A phase 2b, randomized, double-blind, placebo-controlled, parallel-group, multicenter study to evaluate the efficacy, safety, pharmacokinetics, and pharmacodynamics of Usnoflast administered to adult subjects with Amyotrophic Lateral Sclerosis (ALS)
Protocol code: USNO.24.002
Sponsor: Zydus Therapeutics Inc. (Pharmaceutical company). Phase: Therapeutic exploratory (Phase II). Countries: Spain (authorised, recruitment pending), Germany (authorised, recruitment pending), Sweden (authorised, recruiting), Ireland (authorised, recruitment pending), Poland (authorised, recruiting), Italy (authorised, recruitment pending), Belgium (authorised, recruitment pending), France (ongoing, recruiting), Netherlands (ongoing, recruiting).
Therapeutic area(s): Diseases [C] - Nervous System Diseases [C10]
Gender: Female, Male. Age: 18-64 years, 65+ years. Enrolment: 206.
Start date (EU): 2026-07-23. Decision date: 2026-03-12. Results received: No. Last updated: 2026-07-24.
Decision dates by country: IE: 2026-05-15, PL: 2026-05-15, SE: 2026-05-15, NL: 2026-03-25, IT: 2026-03-23, BE: 2026-03-17, DE: 2026-03-18, ES: 2026-05-15, FR: 2026-03-12

Condition(s): Amyotrophic Lateral Sclerosis (ALS)
Product: Usnoflast, Placebo will be identical to Usnoflast capsules in terms of size, shape, and color., Usnoflast

Primary endpoint: Change in disease progression from baseline through 36 weeks, as measured by ALSFRS-R total score and survival
Endpoint(s): 1. Change in SVC from baseline to Week 36, 2. Change in serum levels of NfL protein from baseline to Week 36, 3. Change in ALSFRS-R total score and scores of various functional items/domains of the ALSFRS-R total score from baseline to Week 36, 4. Change in ALSAQ-40 score from baseline to Week 36, 5. Number of TEAEs and SAEs up to Week 36, 6. Assessment of PK in plasma (baseline, Week 16, and Week 36) and CSF (baseline, Week 16, and Week 36), 7. Change in CSF levels of NfL protein from baseline to Week 36, 8. Time from baseline to the occurrence of death or PAV (>22 hours daily for >7 days) (from baseline through Week 36)

Source: https://euclinicaltrials.eu/ctis-public/view/2025-522580-15-00